EU clinical trial 2024-519928-24-00: A Phase 2, Randomized, Open-label, Study of Momelotinib in Participants with Anemia due to Low-risk Myelodysplastic Syndrome.
Protocol code: 223584
Sponsor: Glaxosmithkline Research & Development Limited (Pharmaceutical company). Phase: Therapeutic exploratory (Phase II). Countries: France (ongoing, recruiting), Italy (ongoing, recruiting), Germany (ongoing, recruiting), Poland (ongoing, recruiting), Spain (ongoing, recruiting).
Therapeutic area(s): Diseases [C] - Neoplasms [C04]
Gender: Female, Male. Age: 18-64 years, 65+ years. Enrolment: 56.
Status: Ongoing, recruiting. Start date (EU): 2025-08-21. Decision date: 2025-08-06. Results received: No. Last updated: 2026-07-20.
Decision dates by country: ES: 2025-08-08, IT: 2025-08-07, FR: 2025-08-06, PL: 2025-08-11, DE: 2025-08-06

Condition(s): Myelodysplastic Syndrome

Primary endpoint: 1. Percentage of participants with rolling 12 weeks of RBC-TI by the end of Week 24, 2. Selected safety endpoints: Grade ≥ 3 AE, AEs leading to treatment discontinuation and/or dose modifications, 3. Pharmacokinetic parameters of momelotinib and M21 (e.g., Cmax, AUC), as data permit
Endpoint(s): 3. Percentage of participants with ≥24 weeks RBC-TI by the end of Week 48, 6. Incidence and severity of AEs and SAEs, and AEs leading to treatment discontinuation or dose modifications by the end of Week 24 and longer term, 7. Clinically important changes in laboratory parameters and vital signs by the end of Week 24 and longer term, 8. Plasma concentration of momelotinib and M21, 1. Percentage of participants with rolling ≥16 weeks of RBC-TI by the end of Week 24, 2. Increase in hemoglobin of ≥1.5 g/dL, 4. HI–E response per International Working Group 2018 criteria, 5. Time to RBC-TI by Week 24 and Week 48

Source: https://euclinicaltrials.eu/ctis-public/view/2024-519928-24-00